EU clinical trial 2023-506784-33-00: J2G-MC-JZJX: LIBRETTO-432: A Placebo-controlled Double-Blinded Randomized Phase 3 Study of Adjuvant Selpercatinib following Definitive Locoregional Treatment in Participants with Stage IB-IIIA RET fusion-Positive NSCLC
Protocol code: J2G-MC-JZJX
Sponsor: Eli Lilly & Co. (Pharmaceutical company). Phase: Therapeutic confirmatory (Phase III). Countries: Greece (ended), Sweden (ongoing, recruitment ended), Norway (ended), Spain (ongoing, recruitment ended), Germany (ongoing, recruitment ended), Romania (ended), Belgium (ongoing, recruitment ended), Netherlands (ongoing, recruitment ended), Poland (ended), Czechia (ongoing, recruitment ended), France (ongoing, recruitment ended), Austria (ongoing, recruitment ended), Denmark (ended), Italy (ongoing, recruitment ended).
Therapeutic area(s): Diseases [C] - Neoplasms [C04]
Gender: Female, Male. Age: 18-64 years, 65+ years. Enrolment: 65.
Start date (EU): 2021-01-19. Decision date: 2024-05-23. Results received: No. Last updated: 2026-06-25.
Decision dates by country: PL: 2024-05-27, DK: 2024-05-23, RO: 2024-05-28, GR: 2024-06-07, AT: 2024-05-28, BE: 2024-05-23, FR: 2024-05-24, DE: 2024-05-24, IT: 2024-05-28, ES: 2024-05-24, NL: 2024-05-23, SE: 2024-05-24, CZ: 2024-05-24, NO: 2024-05-23

Condition(s): RET fusion-Positive NSCLC
Product: Placebo to match LY3527723, SELPERCATINIB, Placebo to match LY3527723, SELPERCATINIB

Primary endpoint: EFS by investigator assessment in the primary analysis population

Source: https://euclinicaltrials.eu/ctis-public/view/2023-506784-33-00